EU clinical trial 2024-515639-32-00: Metformin as maintenance therapy in bone sarcomas at high risk of relapse
Protocol code: Metformina-Bone
Sponsor: Istituto Ortopedico Rizzoli (Hospital/Clinic/Other health care facility). Phase: Therapeutic exploratory (Phase II). Countries: Italy (ongoing, recruiting).
Therapeutic area(s): Diseases [C] - Musculoskeletal Diseases [C05]
Gender: Female, Male. Age: 0-17 years, 18-64 years, 65+ years. Enrolment: 67.
Status: Ongoing, recruiting. Start date (EU): 2024-07-30. Decision date: 2024-07-29. Results received: No. Last updated: 2024-07-29.

Condition(s): bone sarcoma
Product: METFORMIN

Primary endpoint: Event Free Survival
Endpoint(s): unexpected metformin toxicity, patient therapy compliance with EORTC QLQ-C30 questionnaire

Source: https://euclinicaltrials.eu/ctis-public/view/2024-515639-32-00